EU clinical trial 2024-518977-32-00: A phase III Randomized Double-Blinded Placebo-Controlled Study of Use of GnRHa during Chemotherapy for Fertility Protection of Young Women and Teenagers with Cancer - ProFertil
Protocol code: ProFertil
Sponsor: Karolinska University Hospital (Hospital/Clinic/Other health care facility). Phase: Therapeutic confirmatory (Phase III). Countries: Sweden (authorised, recruitment pending).
Therapeutic area(s): Diseases [C] - Neoplasms [C04]; Diseases [C] - Hemic and Lymphatic Diseases [C15]
Gender: Female, Male. Age: 0-17 years, 18-64 years. Enrolment: 500.
Status: Authorised, recruitment pending. Decision date: 2024-10-25. Results received: No. Last updated: 2024-10-25.

Condition(s): Breast Cancer, Acute Leukemia, Lymphomas (Hodgkin and non-Hodgkin) ans Sarcomas (Osteo, Soft tissue and Ewing)
Product: 0.9% Sodium Chloride solution containing 9 mg/ml Sodium Chloride in water for injection. Placebo syringes need to be covered with aluminium foil by the unblinded research nurse to maintain the study blind., Pamorelin 3,75 mg pulver och vätska till injektionsvätska, depotsuspension, Pamorelin 11,25 mg pulver och vätska till injektionsvätska, depotsuspension.

Primary endpoint: The difference in recovery of AMH levels at follow-up 12 months after EoT, relative to AMH levels at EoT, as compared between the GnRHa group and the placebo group in women with breast cancer.
Endpoint(s): The difference in recovery of AMH levels at follow-up 12 months after EoT, relative to AMH levels at EoT, between the GnRHa group and the placebo group in women with acute leukemias, lymphomas and sarcomas., Comparison of AFC measured by ultrasound at EoT, 6, 12 months after EoT and continuously during follow-up years 2, 3, 4, 5 after EoT, between the GnRHa group and the placebo group: in women with breast cancer and in woman with acute leukemias, lymphomas and sarcomas., The difference in recovery of AMH levels at 6 months, and follow-up years 2, 3, 4, 5 after EoT, between the GnRHa group and the placebo group: in women with breast cancer and in woman with acute leukemias, lymphomas and sarcomas., Comparison of FSH, inhibin and estradiol performed at EoT, 6, 12 months after EoT and continuously during follow-up years 2, 3, 4, 5 after EoT, between the GnRHa group and the placebo group: in women with breast cancer and in woman with acute leukemias, lymphomas and sarcomas., Comparison of blood flow to the ovarian artery (right and left Doppler flow PI, RI) at baseline, EoT, 6, 12 months after EoT and continuously during follow-up years 2, 3, 4, 5 after EoT, between the GnRHa group and the placebo group: in women with breast cancer and in woman with acute leukemias, lymphomas and sarcomas., Comparison of the proportion that develop amenorrhea (no menstruations) at EoT, 6, 12 months after EoT and continuously during follow-up years 2, 3, 4, 5 after EoT, between the GnRHa group and the placebo group:in women with breast cancer and in woman with acute leukemias, lymphomas and sarcomas., Investigation of the impact of BMI, use of contraceptives and endocrine adjuvant therapy in changes of ovarian reserve with or without GnRHa by longitudinal observation of AMH levels, FSH, inhibin and estradiol at standardized timepoints, Comparison of of pregnancy wish, pregnancy attempts and pregnancy outcomes at EoT, 6, 12 months after EoT and continuously during follow-up years 2, 3, 4, 5 after EoT, between the GnRHa group and the placebo group: in women with breast cancer and in woman with acute leukemias, lymphomas and sarcomas., Comparison of health-related QoL, sexuality and reproductive health examined at EoT, 6, 12 months after EoT and continuously during follow-up years 2, 3, 4, 5 after EoT, between the GnRHa group and the placebo group: in women with breast cancer and in woman with acute leukemias, lymphomas and sarcomas., Comparison of bone mineral density at baseline, EoT and 12 months after EoT and follow-up year 5, between the GnRHa group and the placebo group: in women with breast cancer and in woman with acute leukemias, lymphomas and sarcomas., Investigation of recurrence rate, overall survival and disease-free survival at 12 months after EoT and follow-up years 2, 3, 4, 5 after EoT, between the GnRHa group and the placebo group:in women with breast cancer and in woman with acute leukemias, lymphomas and sarcomas.

Source: https://euclinicaltrials.eu/ctis-public/view/2024-518977-32-00